EU clinical trial 2024-513141-37-00: Immunotherapy with dinutuximab beta in combination with chemotherapy for the treatment of patients with primary neuroblastoma refractory to standard therapy and with relapsed or progressive disease.
Protocol code: ChIm-NB-PL
Sponsor: Uniwersytet Jagiellonski Collegium Medicum (Educational Institution). Phase: Therapeutic confirmatory (Phase III). Countries: Poland (ongoing, recruitment ended).
Therapeutic area(s): Diseases [C] - Neoplasms [C04]
Gender: Female, Male. Age: 0-17 years. Enrolment: 28.
Status: Ongoing, recruitment ended. Start date (EU): 2024-05-06. Decision date: 2024-05-06. Results received: No. Last updated: 2024-05-06.

Condition(s): Recurrent or progression of neuroblastoma or neuroblastoma or neuroblastoma refractory to first-line treatment.
Product: Qarziba 4.5 mg/mL concentrate for solution for infusion

Primary endpoint: number of cycles aborted due to toxicity, number of cycles in which treatment interruptions due to the occurrence of side effects will be longer than provided for in the treatment protocol, number of episodes of Capillary Leak Syndrome, regardless of severity, number of episodes of cytokine release syndrome, regardless of severity, number of episodes of allergic reactions in CTCAE grade 3 and 4 (version in force at that time), number of hematological toxicities in grade 3 and 4 CTCAE (version in force at that time), Number of neurological toxicity episodes, regardless of severity, the percentage of patients with pupil disorders and / or visual disturbances, proportion of patients with renal or hepatic impairment in CTCAE grade 3 and 4 (version in force at that time), Other side effects in grade 3 and 4 CTCAE (version in force at the time)

Source: https://euclinicaltrials.eu/ctis-public/view/2024-513141-37-00